EU clinical trial 2024-514068-14-00: Intrathecal application of PD-1 antibody in metastatic solid tumors with leptomeningeal disease
Protocol code: IT-PD1
Sponsor: Universitaetsklinikum Tuebingen AöR (Hospital/Clinic/Other health care facility). Phase: Phase I and Phase II (Integrated)- Other. Countries: Germany (ongoing, recruiting).
Therapeutic area(s): Diseases [C] - Nervous System Diseases [C10]
Gender: Female, Male. Age: 18-64 years, 65+ years. Enrolment: 54.
Status: Ongoing, recruiting. Start date (EU): 2021-10-12. Decision date: 2024-05-24. Results received: No. Last updated: 2026-04-09.

Condition(s): leptomeningeal disease
Product: OPDIVO 10 mg/mL concentrate for solution for infusion.

Primary endpoint: To assess the maximum tolerable dose and safety of intrathecal (IT) PD-1 antibody administration
Endpoint(s): Overall survival

Source: https://euclinicaltrials.eu/ctis-public/view/2024-514068-14-00